EU clinical trial 2024-518461-10-00: A Phase 3, Randomized, Double-Blind, Placebo-Controlled, Multicenter Study of Mavorixafor in Patients with WHIM Syndrome with Open-Label Extension
Protocol code: X4P-001-103
Sponsor: X4 Pharmaceuticals Inc. (Pharmaceutical company). Phase: Therapeutic confirmatory (Phase III). Countries: Spain (ended), France (ended), Italy (ended), Netherlands (ended), Denmark (ended).
Therapeutic area(s): Phenomena and Processes [G] - Immune system processes [G12]
Gender: Female, Male. Age: 0-17 years, 18-64 years, 65+ years. Enrolment: 6.
Status: Ended. Start date (EU): 2026-01-12. End date (EU): 2026-01-12. Decision date: 2024-11-09. Results received: Yes. Last updated: 2026-04-15.
Decision dates by country: DK: 2024-11-11, FR: 2024-11-12, IT: 2024-12-09, ES: 2024-11-09, NL: 2024-11-11

Condition(s): WHIM Syndrome
Product: Mavorixafor, Placebo to Test IMP

Primary endpoint: Randomized Placebo-Controlled Period: Time above threshold-absolute neutrophil count (TAT-ANC; in hours) of ≥ 500 cells/μL over a 24-hour period, assessed 4 times throughout the study (every 3 months for 12 months) for the Intent-to-Treat (ITT) Population., Open-Label Period: Safety and tolerability of mavorixafor in participants with WHIM syndrome, as assessed by adverse events (AEs), clinical laboratory evaluations, vital signs, electrocardiogram (ECG) assessments, physical and ophthalmologic examinations.
Endpoint(s): Randomized Placebo-Controlled Period: 1. Time above threshold-absolute lymphocyte count (TAT-ALC) of ≥ 1000 cells/μL over a 24-hour period assessed 4 times throughout the study (every 3 months for 12 months) in the ITT Population. 2. Composite Clinical Efficacy Endpoint for mavorixafor based on total infection score and total wart change score in the ITT Population., 3. Total wart change score for mavorixafor based on central blinded, independent review of 3 target skin regions in the ITT Population. 4. Total infection score for mavorixafor based on number and severity of infections adjudicated by a blinded, independent Adjudication Committee (AC) in the ITT Population., Open-Label Period: 1. Proportion of neutrophil responders, defined as participants with ANC ≥ 500 cells/μL threshold. 2. Proportion of lymphocyte responders, defined as participants with baseline ALC below the lower limit of normal who achieve on-treatment ALC ≥ 1000 cells/μL threshold., 3. Absolute and fold change from baseline for total ALC, AMC, ANC, and WBC count. 4. Vaccine titer levels during the Open-Label Period in all participants vaccinated with Tdap) during the study, including pertussis toxin and tetanus., 5. Vaccine titer levels during the Open-Label Period for HPV 16 and HPV 18 in all participants receiving vaccinations with HPV 9-valent vaccine, recombinant (Gardasil®9) during the study. 6. Change from baseline in cutaneous warts, based on central review of CGI-C and CGI-S., 7. Change from baseline in cutaneous warts, based on local dermatologist review of CGI-C and CGI-S. 8. Change over time in PGI-S and PGI-C. 9. Total infection score as adjudicated by an independent AC., For the full list of endpoints please refer to the protocol.

Source: https://euclinicaltrials.eu/ctis-public/view/2024-518461-10-00